EU clinical trial 2024-515591-12-00: Efficacy and safety of Cerebrolysin for neurorecovery after moderate-severe traumatic brain injury
Protocol code: C-RETURN
Sponsor: Foundation For The Study Of Nanoneuroscience And Neuroregeneration (Laboratory/Research/Testing facility). Phase: Phase III and phase IV (Integrated). Countries: Romania (ongoing, recruiting).
Therapeutic area(s): Diseases [C] - Nervous System Diseases [C10]
Gender: Female, Male. Age: 18-64 years, 65+ years. Enrolment: 440.
Status: Ongoing, recruiting. Start date (EU): 2024-08-27. Decision date: 2024-08-27. Results received: No. Last updated: 2025-08-21.

Condition(s): Traumatic brain injury
Product: CEREBROLYSIN, Ser fiziologic 90 mg/10 ml solvent pentru uz parenteral

Primary endpoint: Glasgow Outcome Scale Extended (GOSE) outcome at 90 days after baseline
Endpoint(s): efficacy of Cerebrolysin versus Placebo upon neurological deficit, functional outcome, symptoms of anxiety and depression, drug safety and quality of life 10,45, 90 and 180 days after baseline.

Source: https://euclinicaltrials.eu/ctis-public/view/2024-515591-12-00